EU clinical trial 2023-508853-13-00: EORTC 1740: Randomized Phase II study of Cisplatin plus Radiotherapy versus Durvalumab plus Radiotherapy followed by Adjuvant Durvalumab versus Durvalumab plus Radiotherapy followed by Adjuvant Tremelimumab Durvalumab in Intermediate Risk HPV-Positive Locoregionally Advanced Oropharyngeal Squamous Cell Cancer (LA-OSCC)
Protocol code: EORTC 1740-HNCG
Sponsor: European Organisation For Research And Treatment Of Cancer (Patient organisation/association). Phase: Therapeutic exploratory (Phase II). Countries: Belgium (ongoing, recruitment ended), Spain (ongoing, recruitment ended), Italy (ongoing, recruitment ended).
Therapeutic area(s): Diseases [C] - Neoplasms [C04]
Gender: Female, Male. Age: 18-64 years, 65+ years. Enrolment: 25.
Status: Ongoing, recruitment ended. Start date (EU): 2019-10-31. Decision date: 2024-03-21. Results received: No. Last updated: 2026-07-06.
Decision dates by country: IT: 2024-03-22, ES: 2024-04-01, BE: 2024-03-21

Condition(s): Oropharyngeal Squamous Cell Carcinoma
Product: CISPLATIN, IMFINZI 50 mg/mL concentrate for solution for infusion.

Primary endpoint: Event-free survival (EFS)
Endpoint(s): Overall survival (OS), Loco Regional Control (LRC), Distant Metastasis Free Survival (DMFS), Toxicity, Quality of life

Source: https://euclinicaltrials.eu/ctis-public/view/2023-508853-13-00